EU clinical trial 2023-503221-19-00: A PHASE 2 STUDY OF CEMIPLIMAB (ANTI-PD-1 ANTIBODY) IN COMBINATION WITH BNT116 (FIXVAC LUNG) VERSUS CEMIPLIMAB MONOTHERAPY IN FIRST-LINE TREATMENT OF PATIENTS WITH ADVANCED NON-SMALL CELL LUNG CANCER (NSCLC) WITH TUMORS EXPRESSING PD-L1 ≥50%.
Protocol code: R2810-ONC-2045
Sponsor: Regeneron Pharmaceuticals Inc. (Pharmaceutical company). Phase: Therapeutic exploratory (Phase II). Countries: Spain (ongoing, recruitment ended), Germany (ended), Poland (not authorised).
Therapeutic area(s): Diseases [C] - Neoplasms [C04]
Gender: Female, Male. Age: 18-64 years, 65+ years. Enrolment: 32.
Start date (EU): 2024-04-18. Decision date: 2023-12-15. Results received: No. Last updated: 2026-04-15.
Decision dates by country: PL: 2023-12-18, DE: 2023-12-15, ES: 2023-12-18

Condition(s): Advanced Non-Small Cell Lung Cancer
Product: BNT116, LIBTAYO 350 mg concentrate for solution for infusion.

Primary endpoint: Objective response rate (ORR) as assessed by blinded independent review committee (BIRC) using Response Evaluation Criteria in Solid Tumors version 1.1 (RECIST 1.1)
Endpoint(s): ORR by investigator assessment, Duration of Response (DOR) as assessed by BIRC using RECIST 1.1, DOR by investigator assessment, Progression Free Survival (PFS) as assessed by BIRC using RECIST 1.1, PFS by investigator assessment, Overall Survival (OS), Incidence of treatment-emergent adverse events (TEAEs), Incidences of serious adverse events (SAEs), Incidences of deaths, Incidences of laboratory abnormalities

Source: https://euclinicaltrials.eu/ctis-public/view/2023-503221-19-00